EU clinical trial 2024-512232-30-00: A Double-blind, Randomized, Placebo-Controlled Study and Open-label Long Term Extension to Evaluate the Efficacy and Safety of Elafibranor 80 mg in Patients with Primary Biliary Cholangitis with Inadequate Response or Intolerance to Ursodeoxycholic Acid
Protocol code: GFT505B-319-1
Sponsor: Ipsen Pharma (Pharmaceutical company). Phase: Phase II and Phase III (Integrated). Countries: Belgium (ongoing, recruitment ended), Spain (ongoing, recruitment ended), France (ongoing, recruitment ended), Germany (ongoing, recruitment ended), Italy (ongoing, recruitment ended).
Therapeutic area(s): Diseases [C] - Immune System Diseases [C20]
Gender: Female, Male. Age: 18-64 years, 65+ years. Enrolment: 61.
Status: Ongoing, recruitment ended. Start date (EU): 2021-01-18. Decision date: 2024-09-11. Results received: No. Last updated: 2026-03-30.
Decision dates by country: BE: 2024-09-11, ES: 2024-09-11, DE: 2024-09-12, IT: 2024-09-30, FR: 2024-09-11

Condition(s): Primary Biliary Cholangitis
Product: elafibranor, Placebo

Primary endpoint: Response to treatment at week 52 defined as ALP < 1.67 x ULN and TB ≤ULN and ALP decrease ≥ 15%.
Endpoint(s): Response to treatment based on ALP normalization at week 52., Change in pruritus from baseline through week 52 based on PBC Worst Itch NRS in patients with baseline PBC Worst Itch NRS score ≥4., Change in pruritus from baseline through week 24 based on PBC Worst Itch NRS in patients with baseline PBC Worst Itch NRS score ≥4, Change from baseline in ALP at 4, 13, 26, 39 and 52 weeks, ALP response defined as 10%, 20% and 40% ALP reduction from baseline at week 52, Response to treatment at week 52 according to: a) ALP < 1.5 x ULN, ALP decrease ≥ 40% and TB ≤ ULN b) ALP < 3 x ULN, AST <2x ULN and TB < 1 mg/dL (Paris I) c) ALP ≤ 1.5 x ULN, AST ≤ 1.5x ULN and TB ≤ ULN (Paris II) d) TB response rate of 15% change e) Normalization of abnormal TB and/or albumin (Rotterdam) f) TB ≤ 0.6 x ULN, Response to treatment at week 52 according to: g) ALP ≤ 1.67 x ULN and TB ≤ 1 mg/dL [1] h) No worsening of TB defined as level of TB at week 52 < ULN or no increase from baseline of more than 0.1XULN at week 52 i) Complete biochemical response defined as normal ALP; TB; AST; ALT; albumin; and INR, PBC risk scores at week 52: UK PBC score [2] and GLOBE score [3], Response based on the normalization of bilirubin at week 52, Response based on the normalization of albumin at week 52, Change from baseline to week 52 in hepatobiliary injury and liver function as measured by AST, ALT, GGT, 5' NT, total and conjugated bilirubin, albumin, INR and ALP fractionated (hepatic), Change from baseline to week 52 in biomarkers of inflammation as measured by hsCRP, fibrinogen, haptoglobin and TNF-α, Change from baseline to week 52 in immune response as measured by IgG and IgM, Change from baseline to week 52 in biomarkers, and non-invasive measures of hepatic fibrosis as measured by ELF (HA, PIINP, TIMP-1), PAI-1, TGF-β, CK-18 (M65 and M30), Pro-C3 and liver stiffness measured by TE (continuous), Change from baseline to week 52 in lipid parameters as measured by TC, LDL-C, HDL-C, calculated VLDL-C and triglycerides (TG), Change from baseline to week 52 in FPG, Change from baseline to week 52 in bile acids and biomarkers of bile acid synthesis as measured by bile acids, C4 and FGF-19, Proportion of responders in PBC Worst Itch NRS according to clinically meaningful change; at least 30% reduction; and one point, two points or three points decrease in score from baseline through week 52 and through week 24 in patients with a baseline NRS score ≥ 4, Proportion of patients with no worsening of pruritus from baseline through week 52 and through week 24 as measured by the PBC Worst Itch NRS, Change from baseline to week 52 in 5D-Itch, Change from baseline to week 52 in PROMIS Fatigue Short Form 7a, Change from baseline to week 52 in ESS, Change from baseline to week 52 in PBC-40, Change from baseline to week 52 in health utility as measured by the EQ-5D-5L, Change from baseline to week 52 in serum markers of bone turnover and in bone mineral density (hip and lumbar) assessed by DEXA scanning, Onset of clinical outcomes described as a composite endpoint composed of: a) MELD-Na >14 for patients with baseline MELD-Na <12 b) Liver transplant c) Uncontrolled ascites requiring treatment d) Hospitalization for new onset or recurrence of any of the following: i) variceal bleed ii) hepatic encephalopathy defined as West-Haven score of 2 or more iii) spontaneous bacterial peritonitis e) Death, Safety and tolerability as assessed by: a) SAE, AE, AESI, physical examination, vital signs, medical history, ECG b) Chemistry and hematology c) Liver markers d) Renal biomarkers (including urinalysis) e) Other biochemical safety markers, PK assessments by GFT505 and GF1007 concentrations measurement in plasma

Source: https://euclinicaltrials.eu/ctis-public/view/2024-512232-30-00